EU clinical trial 2024-512925-95-00: C4391024 - An Interventional, Open-Label, Randomized, Multicenter Phase 3 Study of PF-07220060 Plus Letrozole Compared to CDK4/6 Inhibitor Plus Letrozole in Participants Over 18 Years of Age With Hormone Receptor (HR)-Positive, HER2-Negative Advanced/Metastatic Breast Cancer who Have not Received any Prior Systemic Anticancer Treatment for Advanced/Metastatic Disease (FourLight-3)
Protocol code: C4391024
Sponsor: Pfizer Inc. (Pharmaceutical company). Phase: Therapeutic confirmatory (Phase III). Countries: Spain (ongoing, recruitment ended), Czechia (ongoing, recruitment ended), Poland (ongoing, recruitment ended), Belgium (ongoing, recruitment ended), France (ongoing, recruitment ended), Italy (ongoing, recruitment ended), Ireland (ongoing, recruitment ended), Finland (ongoing, recruitment ended), Sweden (ongoing, recruitment ended), Slovakia (ongoing, recruitment ended), Germany (ongoing, recruitment ended), Bulgaria (ongoing, recruitment ended), Denmark (ongoing, recruitment ended), Hungary (ongoing, recruitment ended), Greece (ongoing, recruitment ended), Netherlands (ongoing, recruitment ended).
Therapeutic area(s): Diseases [C] - Neoplasms [C04]
Gender: Female, Male. Age: 18-64 years, 65+ years. Enrolment: 422.
Status: Ongoing, recruitment ended. Start date (EU): 2025-05-16. Decision date: 2025-04-08. Results received: No. Last updated: 2026-08-01.
Decision dates by country: FI: 2025-04-08, IT: 2025-04-09, SE: 2025-04-08, HU: 2025-04-11, IE: 2025-04-11, BE: 2025-04-14, NL: 2025-04-11, DK: 2025-04-08, SK: 2025-04-08, DE: 2025-04-09, PL: 2025-04-14, FR: 2025-04-11, GR: 2025-04-10, ES: 2025-04-09, BG: 2025-04-10, CZ: 2025-04-09

Condition(s): Advanced/Metastatic Breast Cancer
Product: LETROZOLE, IBRANCE 125 mg hard capsules, PF-07220060, ABEMACICLIB, ABEMACICLIB, IBRANCE 100 mg hard capsules, RIBOCICLIB, IBRANCE 75 mg hard capsules, ABEMACICLIB

Primary endpoint: • PFS by blinded independent central review (BICR)
Endpoint(s): • OS

Source: https://euclinicaltrials.eu/ctis-public/view/2024-512925-95-00